EU clinical trial 2024-510616-73-00: Improvement of functional outcome for patients with newly diagnosed grade 2 or 3 glioma with co-deletion of 1p/19q - IMPROVE CODEL: the NOA-18 trial (IMPROVE CODEL)
Protocol code: NOA-18
Sponsor: Universitaetsklinikum Heidelberg AöR (Hospital/Clinic/Other health care facility). Phase: Therapeutic confirmatory (Phase III). Countries: Germany (ongoing, recruiting).
Therapeutic area(s): Diseases [C] - Nervous System Diseases [C10]; Diseases [C] - Neoplasms [C04]
Gender: Female, Male. Age: 18-64 years, 65+ years. Enrolment: 406.
Status: Ongoing, recruiting. Start date (EU): 2020-12-16. Decision date: 2024-09-19. Results received: No. Last updated: 2026-01-20.

Condition(s): newly diagnosed WHO grade 2 or 3 glioma
Product: LOMUSTINE, VINCRISTINE, PROCARBAZINE, TEMOZOLOMIDE, LOMUSTINE

Primary endpoint: The primary efficacy endpoint is overall survival without functional and/or cognitive and/or quality of life deterioration over a period of 90 days, coined qualified overall survival (qOS). Short-term qOS is defined as the time from randomization to, a detriment of ≥ 1.5 standard deviations below the normative mean (i.e. percentile rank ≤ 6.68) in two or more NeuroCog FX® subtests AND Related to baseline: 90%- confidence intervals of NeuroCog FX® subtests indicate a clinically and statistically meaningful individual change (i.e. deterioration) in two or more NeuroCog FX® subtest raw scores* or, related to baseline: a decrease in the KPI from 100 or 90 to 70 or less, a decrease in KPI of at least 20 from 80 or less, or a decrease in KPI from any baseline to 50 or less. Fulfilment of one of these criteria is considered neurological deterioration unless attributable to comorbid events or changes in corticosteroid dose (van den Bent et al. 2011), or, related to baseline: a worsening of at least 10 points, which is the minimal clinically relevant difference, in at least one of the five selected domains of the HrQoL (global health status (GHS), physical functioning (PF), social functioning (SF), determined in the QLQ-C30 with higher scores indicate better HRQoL; communication deficits (CD) & motor dysfunction (MD) determined by QLQ-BN20 with lower scores indicate better HRQoL) (Taphoorn et al. 2015) or, a decline in the NANO scale defined as a ≥2 level worsening from baseline within ≥1 domain or worsening to the highest score within ≥1 domain that is felt to be related to underlying tumor progression and not attributable to a comorbid event or change in concurrent medication (Nayak et al. 2017)., death due to any cause, whatever occurs first.
Endpoint(s): short-term qOS defined as qOS as described above, but neglecting the subsequent time interval of 3 months (90 days). Patients still alive without one of the above defined functional and/or cognitive deterioration criteria at a study visit or lost to follow-up will be censored at the last date they were known to be alive without deterioration., Overall survival (OS) defined as the time from randomization until death due to any cause. Patients still alive will be censored at the last date they were known to be alive., Progression-free survival(PFS) defined as the time from randomization to the day of first documentation of clinical or radiographic tumor progression or death of any cause(whichever occurs first). Patients without a PFS event will be censored at the last disease assessment showing no progression or at baseline if patient has no post-baseline disease assessments. PFS analysis will be based on the central disease assessment by the Central Neuroradiology in the Head Clinic Heidelberg.

Source: https://euclinicaltrials.eu/ctis-public/view/2024-510616-73-00